EU clinical trial 2024-516626-63-00: A clinical study of MK-4646 in healthy people (MK-4646-002)
Protocol code: MK-4646-002
Sponsor: Merck Sharp & Dohme LLC (Pharmaceutical company). Phase: Human Pharmacology (Phase I)- Other. Countries: Belgium (ended).
Therapeutic area(s): Diseases [C] - Virus Diseases [C02]
Gender: Female, Male. Age: 18-64 years. Enrolment: 32.
Status: Ended. Start date (EU): 2024-11-18. End date (EU): 2025-04-11. End date: 2025-04-12. Decision date: 2024-11-18. Results received: No. Last updated: 2024-11-18.

Condition(s): HIV infection

Source: https://euclinicaltrials.eu/ctis-public/view/2024-516626-63-00